EU clinical trial 2024-512264-66-00: An Open-Label, Phase 1/2 Study of ORIC-114 as a Single Agent or in Combination with Chemotherapy, in Patients with Advanced Solid Tumors Harboring an EGFR or HER2 Alteration
Protocol code: ORIC-114-01
Sponsor: ORIC Pharmaceuticals Inc. (Pharmaceutical company). Phase: Phase I and Phase II (Integrated)- First administration to humans. Countries: Poland (ongoing, recruiting), Spain (ongoing, recruiting).
Therapeutic area(s): Diseases [C] - Neoplasms [C04]
Gender: Female, Male. Age: 18-64 years, 65+ years. Enrolment: 30.
Status: Ongoing, recruiting. Start date (EU): 2025-01-29. Decision date: 2024-09-16. Results received: No. Last updated: 2026-06-11.
Decision dates by country: PL: 2024-09-16, ES: 2024-11-25

Condition(s): Solid Tumors
Product: ORIC-114

Primary endpoint: Part I: Provisional RP2Ds and/or MTD of ORIC-114., Part II: Optimal ORIC-114 RP2D., Part III: RP2D and/or MTD of ORIC-114 in combination with carboplatin-pemetrexed, Incidence of adverse events, vital signs, evaluation of clinical laboratory results, 12-lead electrocardiogram (ECG), and other clinical assessments., PK profile as measured by Tmax, Cmax, Clast, AUClast, AUCtau, AUCinf, Kel, t1/2, CL/F, Vz/F, Rac(Cmax), and Rac(AUC) as appropriate
Endpoint(s): Assessed according to Response Evaluation Criteria in Solid Tumors (RECIST) 1.1 • Objective response rate (ORR) (complete response [CR] or partial response [PR]), measured as changes in target and non-target lesions relative to baseline every 8 weeks • Duration of response (DOR), defined as time of first response to first documentation of radiographic progression or death, whichever occurs first., • Clinical benefit rate (CBR) (CR, PR, or stable disease [SD] ≥6 months) • Progression-free survival (PFS), defined as time from first dose of ORIC-114 to first documentation of radiographic progression or death, whichever occurs first, Intracranial response will be assessed according to modified RECIST 1.1 and/or RANO-BM • Intracranial response rate (CR or PR) measured as changes in target and non-target CNS lesions • Intracranial PFS, defined as time from first dose of ORIC-114 to first documentation of radiographic progression in the brain or death, whichever occurs first.

Source: https://euclinicaltrials.eu/ctis-public/view/2024-512264-66-00